EU clinical trial 2024-519019-32-00: PREDIX Luminal B - Neoadjuvant response-guided treatment of estrogen receptor positive tumors with high proliferation or slow proliferation with metastatic nodes. Part of a platform of translational phase II trials based on molecular subtypes.
Protocol code: PREDIX LumB
Sponsor: Karolinska University Hospital (Hospital/Clinic/Other health care facility). Phase: Therapeutic exploratory (Phase II). Countries: Sweden (ongoing, recruitment ended).
Therapeutic area(s): Diseases [C] - Neoplasms [C04]
Gender: Female, Male. Age: 18-64 years, 65+ years. Enrolment: 180.
Status: Ongoing, recruitment ended. Start date (EU): 2014-12-05. Decision date: 2024-10-28. Results received: No. Last updated: 2026-07-28.

Condition(s): Early breast cancer
Product: Letrozole Sandoz 2,5 mg filmdragerade tabletter, TAMOXIFEN SANDOZ 20 mg, Paclitaxel Accord 6 mg/ml koncentrat till infusionsvätska, lösning, IBRANCE 125 mg film-coated tablets, Exemestan Sandoz 25 mg, filmdragerade tabletter, Anastrozol Sandoz 1 mg filmdragerade tabletter

Primary endpoint: Absolute difference in clinical and radiological objective response after completion of the first 12-week period of primary medical treatment
Endpoint(s): Pathological objective response to primary medical treatment, Sequencing of chemotherapy versus endocrine treatment plus palbociclib, Morphological, functional and biological characteristics of tumors exposed to cytotoxic and targeted treatment of early breast cancer, Event-free survival (EFS), invasive disease-free survival (IDFS), distant disease-free survival (DDFS), breast cancer-specific survival (BCSS) and overall survival (OS), Safety, Quality of life, Frequency of breast-conserving surgery

Source: https://euclinicaltrials.eu/ctis-public/view/2024-519019-32-00